EU clinical trial 2023-508115-23-00: An open label, balanced, randomized, single dose, two treatment, two period, two sequence, crossover, bioequivalence study comparing Ivacaftor film coated tablets 150 mg of Sun Pharmaceutical Industries Ltd, India with Kalydeco (Ivacaftor) 150 mg film-coated tablets, Marketing Authorisation Holder: Vertex Pharmaceuticals (Ireland) Limited Unit 49, Block F2, Northwood Court, Santry, Dublin 9, D09 T665, Ireland, in healthy adult, human subjects under fed condition.
Protocol code: IVACA-05-23
Sponsor: Sun Pharmaceutical Industries Limited (Pharmaceutical company). Phase: Human Pharmacology (Phase I)- Bioequivalence Study. Countries: Romania (ended).
Therapeutic area(s): Phenomena and Processes [G] - Genetic Phenomena [G05]
Gender: Female, Male. Age: 18-64 years. Enrolment: 52.
Status: Ended. Start date (EU): 2024-02-20. End date (EU): 2024-03-28. Decision date: 2024-02-12. Results received: No. Last updated: 2024-02-12.

Condition(s): Cystic Fibrosis

Source: https://euclinicaltrials.eu/ctis-public/view/2023-508115-23-00